EU clinical trial 2024-514398-23-00: A Phase I/IIa open label single ascending dose study to investigate the safety and tolerability of regulatory T cells as an adjunctive therapy in deceased-donor kidney recipients - ProTreg
Sponsor: Charite Universitaetsmedizin Berlin KöR (Hospital/Clinic/Other health care facility). Phase: Phase I and Phase II (Integrated)- Other. Countries: Germany (ongoing, recruiting).
Therapeutic area(s): Analytical, Diagnostic and Therapeutic Techniques and Equipment [E] - Therapeutics [E02]
Gender: Female, Male. Age: 18-64 years, 65+ years. Enrolment: 27.
Status: Ongoing, recruiting. Start date (EU): 2024-06-10. Decision date: 2024-11-01. Results received: No. Last updated: 2026-05-11.

Condition(s): Solid organ transplantation (Kidney)
Product: Cotrim-ratiopharm® 400 mg/80 mg Tabletten, Ampho-Moronal Lutschtabletten, CellCept 500 mg film-coated tablets, Envarsus 1 mg prolonged-release tablets, Histakut Dimetindenmaleat 1 mg/ml Injektionslösung, Urbason 4 mg Tabletten, Advagraf 1 mg prolonged-release hard capsules, Paracetamol-ratiopharm® 1000 mg Tabletten, Urbason solubile forte 250 mg Pulver und Lösungsmittel zur Herstellung einer Injektionslösung/Infusionslösung, Prograf 0,5 mg Hartkapseln, Thymoglobuline 5 mg/ml, Pulver zur Herstellung einer Infusionslösung., Valganciclovir-ratiopharm® 450 mg Filmtabletten, Treg02

Primary endpoint: Primary safety endpoint 1: Acute toxicity associated with infusion of Treg02, assessed by evidence of: (a) pulmonary complications, (b) immunological reactions resulting in anaphylactic reactions, immediate cardiovascular compromise or other acute organ failure, (c) Treg therapy associated biochemical perturbation (significant deviations in biomarker data) as assessed by the immunological impact of the infused cells or apoptosis of Tregs and release of cellular contents., Primary safety endpoint 2: Over-suppression of the immune system by assessing evidence of: (a) major and/or opportunistic infections, especially increased frequency of cytomegalovirus (CMV), Epstein-Barr virus (EBV) and polyomavirus reactivation and/or disease, (b) early development of neoplasia, Primary safety endpoint 3: Chronic toxicity associated with Treg02 infusions, measured by evidence of: (a) malignancies arising directly from adoptive cellular therapy, (b) autoimmune disorders, (c) inflammatory pathologies, (d) anaemia, cytopenia or biochemical anomalies unrelated to the transplanted kidney functions, Primary clinical endpoint: Biopsy-confirmed acute rejection (BCAR) within 60 weeks of organ transplantation
Endpoint(s): Secondary indices of efficacy 1: Prevention of acute rejection (a): time to first acute rejection, b): severity of acute rejection episodes based on response to treatment and histological scoring, c): level of total immunosuppression at the final trial visit), Secondary indices of efficacy 2: Incidence of patients treated for subclinical acute rejection based on histopathological findings, Secondary indices of efficacy 3: Prevention of chronic graft dysfunction (chronic rejection or interstitial fibrosis/tubular atrophy) assessed by clinically impaired glomerular filtration rate (GFR) and histopathological (Banff staging) criteria measures, Secondary indices of efficacy 4: Incidence of post-transplant dialysis, inclusion on the transplant waiting list, or re-transplantation following graft loss through rejection (acute or chronic), Secondary indices of efficacy 5: Reduced incidence of adverse events/rejections following tapering of immunosuppression (e.g. cardiovascular complications, drug toxicity, etc.), Biomarker panel: measure functional and molecular indices reflecting the immune response as well as treatment safety and efficacy of regulatory T cells, Quality-of-life using the SF-12 QoL health survey

Source: https://euclinicaltrials.eu/ctis-public/view/2024-514398-23-00